EU clinical trial 2025-523874-17-00: A Phase 1/2 First-Time-in-Human, open-label, multicenter, dose escalation and dose optimization study of GSK5471713 in adult participants with metastatic castration resistant prostate cancer (mCRPC).
Protocol code: 300164
Sponsor: Glaxosmithkline Research & Development Limited (Pharmaceutical company). Phase: Phase I and Phase II (Integrated)- First administration to humans. Countries: Netherlands (authorised, recruitment pending), France (authorised, recruitment pending), Spain (authorised, recruitment pending).
Therapeutic area(s): Diseases [C] - Neoplasms [C04]
Gender: Male. Age: 18-64 years, 65+ years. Enrolment: 18.
Status: Authorised, recruitment pending. Decision date: 2026-07-21. Results received: No. Last updated: 2026-07-27.
Decision dates by country: FR: 2026-07-21, ES: 2026-07-27, NL: 2026-07-21

Condition(s): Neoplasms, Prostate

Primary endpoint: Number of participants with dose limiting toxicities (DLTs) at each dose level, Number of participants with adverse events (AEs), serious adverse events (SAEs) and AEs leading to dose modifications, Severity of adverse events (AEs), serious adverse events (SAEs) and AEs leading to dose modifications
Endpoint(s): Area under the plasma concentration-time curve from 0 to t (AUC[0-t]) of GSK5471713, Maximum plasma concentration (Cmax) of GSK5471713, Time to maximum plasma concentration (tmax) of GSK5471713, Prostate-specific antigen decrease from baseline >=50% (PSA50) response rate, Objective response rate (ORR) per Prostate Cancer Working Group 3 (PCWG3) by investigator assessment

Source: https://euclinicaltrials.eu/ctis-public/view/2025-523874-17-00